EU clinical trial 2025-524040-35-00: A Phase 3, Randomized, Double-Blind, Placebo-Controlled Study to Assess the Efficacy and Safety of GB-0895 Adjunctive Therapy in Adults and Adolescents with Severe Uncontrolled Asthma
Protocol code: GB-0895-302
Sponsor: Generate Biomedicines Inc. (Pharmaceutical company). Phase: Therapeutic confirmatory (Phase III). Countries: Italy (authorised, recruitment pending), Slovakia (authorised, recruitment pending), Spain (authorised, recruitment pending), Ireland (authorised, recruitment pending), Belgium (authorised, recruitment pending), France (authorised, recruitment pending), Estonia (authorised, recruitment pending).
Therapeutic area(s): Diseases [C] - Respiratory Tract Diseases [C08]
Gender: Female, Male. Age: 0-17 years, 18-64 years, 65+ years. Enrolment: 80.
Status: Authorised, recruitment pending. Decision date: 2026-05-26. Results received: No. Last updated: 2026-08-05.
Decision dates by country: BE: 2026-05-26, IT: 2026-05-27, SK: 2026-05-26, ES: 2026-05-27, FR: 2026-06-01, EE: 2026-07-28, IE: 2026-05-29

Condition(s): Severe uncontrolled asthma
Product: GB-0895, 0.9% sodium chloride

Primary endpoint: Annualized asthma exacerbation rate (AAER) of clinically significant exacerbations over 52 weeks, defined as exacerbations requiring systemic corticosteroids (oral, intravenous [IV], or intramuscular) and/or hospitalization or emergency department visits requiring systemic corticosteroids
Endpoint(s): • AAER over 52 weeks • Change from baseline in pre-bronchodilator (BD) forced expiratory volume in 1 second (FEV1) at Week 52 • Change from baseline in Asthma Quality of Life Questionnaire (AQLQ(S)12+) score at Week 52, • Change from baseline in Asthma Control Questionnaire (ACQ-6) score at Week 52 • Time to first clinically significant exacerbation from randomization, • Change from baseline in weekly mean daily Asthma Daytime Symptom Diary (ADSD) score at Week 52 • Change from baseline in weekly mean daily Asthma Nighttime Symptom Diary (ANSD) score at Week 52

Source: https://euclinicaltrials.eu/ctis-public/view/2025-524040-35-00